EU clinical trial 2024-512649-18-00: A Phase 3, Multi-center, Randomized, Quadruple-masked, Placebo-controlled Study of Batoclimab for the Treatment of Participants with Active Thyroid Eye Disease (TED)
Protocol code: IMVT-1401-3202
Sponsor: Immunovant Sciences GmbH (Pharmaceutical company). Phase: Therapeutic confirmatory (Phase III). Countries: Slovakia (ended), Spain (ended), Hungary (ended), Germany (ended), Belgium (ended), Latvia (ended).
Therapeutic area(s): Diseases [C] - Eye Diseases [C11]
Gender: Female, Male. Age: 18-64 years, 65+ years. Enrolment: 75.
Status: Ended. Start date (EU): 2023-06-05. End date (EU): 2026-03-03. End date: 2026-03-04. Decision date: 2024-07-02. Results received: No. Last updated: 2025-12-18.
Decision dates by country: SK: 2024-07-02, LV: 2024-07-02, HU: 2024-07-02, ES: 2024-07-05, BE: 2024-07-02, DE: 2024-07-04

Condition(s): Thyroid Eye Disease
Product: Placebo is identical to IMP but with no active substance., Batoclimab

Primary endpoint: Proportion of proptosis responders (proptosis responder rate) at Week 24 where proptosis responder is defined as the participant with a ≥ 2 mm reduction in the study eye without deterioration (≥ 2 mm increase) in the fellow eye.
Endpoint(s): Proportion of participants with proptosis ≥ 2 mm reduction and CAS ≤ 3 at Week 24 from baseline in the study eye., Proportion of participants with CAS of 0 or 1 at Week 24 in the study eye., Mean change from baseline to Week 24 in CAS in the study eye., Proportion of participants with positive binding anti-TSHR Ab at baseline who achieve seroconversion at Week 24., Proportion of participants with decrease of at least 1 grade from baseline in Gorman score for diplopia at Week 24 in participants who have diplopia at baseline., Mean change from baseline to Week 24 in proptosis (mm) in the study eye., Proportion of participants with ≥ 6-point increase from baseline in total GO-QOL score at Week 24 in participants who have the ability to increase by ≥ 6 points from baseline., Proportion of participants with ≥8 degree increase from baseline in motility (in at least 1 of 4 directions) at Week 24 in the study eye in participants who have the ability to increase by ≥ 8 degrees from baseline.

Source: https://euclinicaltrials.eu/ctis-public/view/2024-512649-18-00